EU clinical trial 2024-518836-36-00: Respiratory effect of the LISA (Less Invasive surfactant administration) method with sedation by propofol versus absence of sedation: Double-blind comparative randomized clinical trial
Protocol code: 38RC18.123
Sponsor: Centre Hospitalier Universitaire Grenoble Alpes (Hospital/Clinic/Other health care facility). Phase: Therapeutic confirmatory (Phase III). Countries: France (ongoing, recruitment ended).
Therapeutic area(s): Analytical, Diagnostic and Therapeutic Techniques and Equipment [E] - Anesthesia and Analgesia [E03]
Gender: Female, Male. Age: 0-17 years. Enrolment: 542.
Status: Ongoing, recruitment ended. Start date (EU): 2019-10-07. Decision date: 2024-12-02. Results received: No. Last updated: 2026-04-22.

Condition(s): Respiratory Distress Syndrome of preterm babies born < 32 weeks of gestational age
Product: PROPOFOL LIPURO 1 % (10 mg/ml), émulsion injectable ou pour perfusion, MEDIALIPIDE 20 POUR CENT, émulsion pour perfusion, KETAMINE RENAUDIN 10 mg/ml, solution injectable

Primary endpoint: Rate of MV from the start of the LISA procedure up to 72 hours of life in each group.
Endpoint(s): Rate of MV from the start of the LISA procedure up to 72 hours of life in each class of GA (<28, 28-31wGA), Faceless Acute Neonatal Scale (FANS) assessed during the LISA: this scale evaluates behavioral items (limb movements, vocal expression) and physiological items (heart rate variation, bradycardia or desaturation), on a scale from 0 (no pain) to 10 (maximal pain)., Rate of ketamine administration for rescue: This administration will be indicated after two (< 28 wGA) or 3 (28 – 31 wGA) administrations of the drug, if adequate comfort is not achieved (FANS≥6 or baby not comfortable), Quality conditions, To assess BPD at 36wGA, In-hospital neonatal morbidity and mortality, At two years : ASQ questionnaire, Gross Motor Function Classification Scale in cases of motor impairment, Visual and hearing function

Source: https://euclinicaltrials.eu/ctis-public/view/2024-518836-36-00